EU clinical trial 2023-507427-28-00: A randomised, double-blind, placebo-controlled clinical trial to evaluate the efficacy and safety of PQ Birch in subjects with seasonal allergic rhinitis and/or rhinoconjunctivitis induced by birch pollen exposure
Protocol code: PQBirch302
Sponsor: Allergy Therapeutics (UK) Limited (Pharmaceutical company). Phase: Therapeutic confirmatory (Phase III). Countries: Austria (authorised, recruitment pending), Germany (authorised, recruitment pending), Poland (authorised, recruitment pending).
Therapeutic area(s): Diseases [C] - Immune System Diseases [C20]
Gender: Female, Male. Age: 18-64 years, 65+ years. Enrolment: 562.
Status: Authorised, recruitment pending. Decision date: 2024-10-22. Results received: No. Last updated: 2024-10-28.
Decision dates by country: AT: 2024-10-28, DE: 2024-10-22, PL: 2024-10-28

Condition(s): seasonal allergic rhinitis and/or rhinoconjunctivitis
Product: Placebo: 2% (w/v) L-tyrosine and 0.5% (w/v) phenol for subcutaneous use, Pollinex Quattro Plus 1.0 mL Birch

Primary endpoint: CSMS averaged over the peak BPS.
Endpoint(s): Secondary Efficacy: - CSMS averaged over the entire BPS. - The dSS component of the CSMS averaged over the peak BPS. - The dMS component of the CSMS averaged over the peak BPS. - The TCS averaged over the peak BPS. - CSMS averaged over the combined peak seasons for alder, hazel, birch and oak pollen season (peak TPS). - RQLQ(S) measured at Visit 11., - Serum birch-specific IgG4 at pre-BPS (Visit 9) compared to baseline., Safety: - Frequency, severity and relationship of AEs to treatment. - Frequency of AEs leading to premature discontinuation from treatment or clinical trial. - Changes in clinical laboratory values (serum chemistry, haematology and urinalysis) between screening and Visit 12. - Changes in vital signs at all treatment visits.

Source: https://euclinicaltrials.eu/ctis-public/view/2023-507427-28-00